EU clinical trial 2024-518088-37-01: A Phase I Open-Label, Dose-escalation Clinical Trial of Tumor Necrosis Factor Alpha and Interleukin-2 Coding Oncolytic Adenovirus TILT-123 in combination with avelumab in injectable solid tumor patients (melanoma and SCCHN) refractory to or progressing after anti-PD(L)1 immunotherapy
Protocol code: TILT-T776
Sponsor: TILT Biotherapeutics Oy (Pharmaceutical company). Phase: Human Pharmacology (Phase I)- Other. Countries: Finland (ended).
Therapeutic area(s): Diseases [C] - Neoplasms [C04]
Gender: Female, Male. Age: 18-64 years, 65+ years. Enrolment: 9.
Status: Ended. Start date (EU): 2024-12-04. End date (EU): 2026-03-11. End date: 2026-07-29. Decision date: 2024-12-04. Results received: No. Last updated: 2025-12-10.

Condition(s): Melanoma, SCCHN

Source: https://euclinicaltrials.eu/ctis-public/view/2024-518088-37-01